EU clinical trial 2024-517749-15-00: LIDOCRIT : Effect of continuous intravenous LIDOCaine on discomfort in postoperative CRITical care inpatients
Protocol code: 35RC22_8943_LIDOCRIT
Sponsor: Centre Hospitalier Universitaire De Rennes (Hospital/Clinic/Other health care facility). Phase: Phase III and phase IV (Integrated). Countries: France (ongoing, recruiting).
Therapeutic area(s): Analytical, Diagnostic and Therapeutic Techniques and Equipment [E] - Anesthesia and Analgesia [E03]
Gender: Female, Male. Age: 18-64 years, 65+ years. Enrolment: 246.
Status: Ongoing, recruiting. Start date (EU): 2026-06-12. Decision date: 2025-06-25. Results received: No. Last updated: 2026-02-10.

Condition(s): Postoperative critical care
Product: SODIUM CHLORIDE, LIDOCAINE HYDROCHLORIDE MONOHYDRATE

Primary endpoint: Overall score on the IPREA questionnaire (Inconforts of REAnimation Patients with 18 items). Within 24 hours before discharge from critical care or, failing that, within 24 hours before the 15th day of hospitalization in critical care. Deceased patients will be considered non-evaluable.
Endpoint(s): Result per item of 8 items of the IPREA score, Within 24 hours before discharge from critical care or, failing that, within 24 hours before the 15th day of hospitalisation in critical care: - Noise - Thirst - Pain - Medical devices (catheters, intubation tubes, etc.) - Sleepiness - Dyspnoea - Anxiety - Depression. Deceased patients will be considered ineligible for evaluation., Cumulative opiate consumption over the first 6 post-operative days (in equivalent mg of IV morphine, or µg of Remifentanil or µg of Sufentanil). In the event of death or premature discharge, the criterion will be assessed over the period preceding the death or discharge., The duration of invasive mechanical ventilation in critical care. Until discharge from critical care, including, in the event of transfer, the stay in critical care in the transfer hospital, or, failing that, until day 30. In the event of death or premature discharge, the criterion will be assessed over the period preceding death or discharge., Re-intubation within 48 hours of extubation (until discharge from critical care, including, in the case of transfer, the stay in critical care at the receiving hospital, or, failing that, until day 30). In the event of death or premature discharge, the criterion will be assessed over the period preceding death or discharge., The duration of sedation. Until discharge from critical care, including, in the event of transfer, the stay in critical care in the transfer hospital, or, failing that, until day 30. In the event of death or premature discharge, the criterion will be assessed over the period preceding death or discharge., The length of stay in critical care, including, in the event of transfer, the stay in critical care in the transfer hospital, over a maximum period of 30 post-operative days. Up to day 30. In the event of death or premature discharge, the criterion will be assessed over the period preceding the death or discharge., The total length of hospital stay including, in the event of transfer, the stay in the transfer hospital, over a maximum period of 30 post-operative days. Up to day 30. In the event of death or premature discharge, the criterion will be assessed over the period preceding the death or discharge., Vital status on the 30th postoperative day. J30. In case of premature discharge, the vital status will be censored as of the discharge date., The incidence of care-associated pneumonia (RFE SFAR/SRLF 2017 ‘Care-associated pneumonia’ criteria in appendix). During the stay in critical care, including, in the event of transfer, the stay in critical care in the transfer hospital, up to day 30. In the event of death or premature discharge, the criterion will be assessed over the period preceding the death or discharge., The incidence of delirium (measured by CAM ICU). During the stay in critical care, including, in the event of transfer, the stay in critical care in the transfer hospital, up to day 30. In the event of death or premature discharge, the criterion will be assessed over the period preceding the death or discharge., The incidence of adverse reactions attributable to lidocaine over the duration of treatment administration and 24 hours after the end of treatment administration. In the event of death or premature discharge, the criterion will be assessed over the period preceding the death or discharge., Sensitivity analysis : Overall score on the IPREA questionnaire. Data collected within 24 hours prior to discharge from critical care or, failing that, within 24 hours prior to the 15th day of hospitalisation in critical care. Data for deceased patients will be imputed according to the following strategy: - values for patients who died before day 7 will be assigned to the most unfavorable IPREA score (100), - values for patients who died after day 7 will be assigned by multiple imputation., Overall score on the IPREA questionnaire. Within 24 hours prior to the 7th day of hospitalization in critical care. Deceased patients will be considered ineligible for evaluation.

Source: https://euclinicaltrials.eu/ctis-public/view/2024-517749-15-00